EU clinical trial 2022-501050-11-01: ALLTogether1 - A Treatment Study Protocol of the ALLTogether Consortium for Children and Young Adults (0-45 Years of Age) with Newly Diagnosed Acute Lymphoblastic Leukaemia (ALL)
Protocol code: ALLTogether1
Sponsor: Karolinska University Hospital (Hospital/Clinic/Other health care facility). Phase: Phase II and Phase III (Integrated). Countries: Norway (ongoing, recruiting), Denmark (ongoing, recruiting), Netherlands (ongoing, recruiting), Lithuania (ongoing, recruiting), Finland (ongoing, recruiting), Germany (ongoing, recruiting), Ireland (ongoing, recruiting), Iceland (ongoing, recruiting), France (ongoing, recruiting), Belgium (ongoing, recruiting), Estonia (ongoing, recruiting), Sweden (ongoing, recruiting), Portugal (ongoing, recruiting), Spain (authorised, recruiting).
Therapeutic area(s): Diseases [C] - Neoplasms [C04]
Gender: Female, Male. Age: 0-17 years, 18-64 years. Enrolment: 6203.
Start date (EU): 2020-07-13. Decision date: 2024-10-15. Results received: No. Last updated: 2026-04-28.
Decision dates by country: EE: 2024-10-21, BE: 2024-10-16, NO: 2024-10-15, SE: 2024-10-15, ES: 2025-12-11, FI: 2024-10-17, FR: 2024-10-15, IE: 2024-10-15, PT: 2024-10-15, LT: 2024-11-04, NL: 2024-10-15, DK: 2024-10-23, DE: 2024-10-17, IS: 2024-11-29

Condition(s): Acute Lymphoblastic Leukaemia
Product: BLINCYTO 38.5 micrograms powder for concentrate and solution for solution for infusion, HYDROCORTISONE SODIUM SUCCINATE, METHOTREXATE, MERCAPTOPURINE, MERCAPTOPURINE, METHOTREXATE, MERCAPTOPURINE, DEXAMETHASONE, MERCAPTOPURINE, CYTARABINE, IMATINIB, VINCRISTINE SULFATE, TIOGUANINE, BESPONSA 1 mg powder for concentrate for solution for infusion, HYDROCORTISONE SODIUM PHOSPHATE, METHOTREXATE, METHYLPREDNISOLONE SODIUM SUCCINATE, DOXORUBICIN, PREDNISOLONE SODIUM SUCCINATE, DEXAMETHASONE, VINCRISTINE SULFATE

Primary endpoint: The primary endpoint for the whole protocol (compared with the legacy protocols of the participating study-groups forming the consortium) is event-free survival (EFS) - as defined in the protocol., The primary endpoint for the randomised interventions is disease-free survival (DFS) - as defined in the protocol., The primary endpoint for the replacement of conventional chemotherapy for patients with Down syndrome and detectable MRD at the end of induction (ALLTogether1 DS) is the fraction of patients with undetectable MRD after one cycle of blinatumomab. This fraction will be compared with a well defined historic control cohort from the UKALL2011 protocol.
Endpoint(s): Main study - The most important secondary outcome is overall survival (OS)., Main study - Additional secondary measures of antileukaemic efficacy are: rate of -death during induction, -resistant disease, cumulative incidence of: -relapse (ciR), -death in first complete remission (ciDCR1) and -second malignancy (ciSMN)., Main study - Over- and under-treatment will also be combined into resulting treatment-related mortality (TRM) and leukaemia specific mortality (LSM) rates., Main study - Since over-treatment also includes cured patients who suffer potentially permanent side-effects, data will be collected regarding the incidence of some adverse events of special interest. De-escalation of therapy may also result in relapses that have to be rescued with allogeneic stem-cell transplant (allo-SCT), which is associated with serious permanent side effects. Therefore, the incidence of allo-HSCT in CR1 and CR2 will also be measured., Main study - An important aspect of evaluation of the quality of survival is measurement of quality of life (QoL). The whole protocol, as well as each of the non-randomised and randomised interventions will also be evaluated by measurements of quality of life (QoL). QoL will be measured by EQ5D-based instruments before and after all the randomised phases in all randomisations as well as later in the therapy and after cessation of treatment., R1 and R2 - Efficacy: - Overall survival (OS), - Cumulative incidence of relapse (ciR), - Cumulative incidence of Death in CR1 (ciDCR1), - Cumulative incidence of SMN (ciSMN), - Fraction of surviving patients treated with allogenic stem-cell transplant in second remission, - Cumulative incidence of HSCT in CR2, R1 and R2 - Toxicity: The studies are powered to answer the primary end-point non-inferiority question with a certain safety-margin. Even if reduction of exposure to potentially toxic therapy is an objective in itself, it is also reasonable to show some immediately measurable benefit from the reduction of therapy if the study is successful and non-inferiority can be shown., Non-lethal toxicities for the DI-phase (R1 and R2): - Rate of febrile neutropenia (yes/no) and agent (if isolated from a sterile site/blood), -Rate of invasive fungal infection (yes/no) together with assessment if "possible"/"probable"/"proven" and agent (if isolated from sterile site/blood/BAL), -Rate of serious viral reactivation (EBV, VZV, HSV, CMV), mucositis with need for intravenous analgesic and/or nutritional support with parenteral nutrition, - The incidence of SAEs (except AESI), Non-lethal toxicities for the DI-phase (R1 and R2): -The time-interval between the start of DI and the start of the next treatment- phase in days, - Rate of cardiac failure or serious arrhytmia (CTCAE ≥ grade 3)., Quantifiable measures of the toxicities listed above (measured at the same time-points): -Days admitted to hospital during the randomised phase and until the start of the next treatment phase, -days on iv antibiotics, - days on advanced antifungals, -days on iv analgesics and/or nutritional support with parenteral nutrition., Non-lethal toxicity for the Maintenance-phase (R2) Measured at the beginning of Maintenance and every 4 months during the maintenance-phase: -Rate of VCR-neuropathy Grade ≥3 according to the PdL definition, -The number of doses of VCR that had to be reduced or omitted, -Cumulative incidence of symptomatic osteonecrosis + grade., Follow-up end-point of obesity: Body-mass index at the time of cessation of therapy and 5 years after the end of therapy., R3-InO and R3-TEAM secondary endpoints - Efficacy: -Overall survival (OS), - Cumulative incidence of relapse (ciR), -Occurence of CD22 negative relapse (InO), -Relation of all adverse outcomes with DNA-TG (TEAM)., R3-InO and R3-TEAM - Toxicity: -Incidence and severity of SOS/VOD all grades, - Incidence and severity of other liver toxicity (defined as AST/ALT elevations grade > 3 and bilirubin grade >3), Toxicity InO: -Incidence and severity of infections CTCAE grade > 3, -Incidence and duration of B-cell depletion reflected by immunoglobulin levels/IV immunoglobulin supplementation, Toxicity TEAM: -Cumulative incidence of SMN (ciSMN; TEAM), -Cumulative Incidence of NRH, -Cumulative Incidence of osteonecrosis, -Cumulative Incidence of hypoglycaemia, Exploratory endpoint (InO): CD22 expression level of leukemic cells in bone marrow samples at diagnosis and at TP2 (day 71)., ALLTogether1 DS secondary endpoints: -Event-Free Survival (EFS), -Overall Survival (OS), -Cumulative incidence of relapse (ciR) and CD19 negative relapse, -Cumulative incidence of Death in CR1 (ciDCR1), -Cumulative incidence of SMN (ciSMN), -Cumulative incidence of blinatumomab refractory disease, -Cumulative incidence of Protocol Therapy Failure, Exploratory endpoint ALLTogether1 DS: MRD response at any timepoint within 2 cycles of blinatumomab

Source: https://euclinicaltrials.eu/ctis-public/view/2022-501050-11-01